EU clinical trial 2023-506961-74-00: Efficacy and safety investigation of NNC0194-0499 co-administered with semaglutide in subjects with non-alcoholic steatohepatitis: a dose-ranging, placebo-controlled trial.
Protocol code: NN9500-4656
Sponsor: Novo Nordisk A/S (Pharmaceutical company). Phase: Therapeutic exploratory (Phase II). Countries: Germany (ended), France (ended), Italy (ended), Denmark (ended), Spain (ended), Poland (ended), Czechia (ended), Belgium (ended), Portugal (ended), Bulgaria (ended), Greece (ended).
Therapeutic area(s): Diseases [C] - Digestive System Diseases [C06]
Gender: Female, Male. Age: 18-64 years, 65+ years. Enrolment: 165.
Status: Ended. Start date (EU): 2021-08-31. End date (EU): 2025-03-07. End date: 2025-03-14. Decision date: 2024-05-21. Results received: Yes. Last updated: 2025-01-22.
Decision dates by country: DK: 2024-05-21, FR: 2024-05-23, PL: 2024-05-27, PT: 2024-05-22, BG: 2024-07-01, ES: 2024-05-22, DE: 2024-05-28, BE: 2024-05-27, GR: 2024-07-04, IT: 2024-05-29, CZ: 2024-05-27

Condition(s): Non-alcoholic steatohepatitis (NASH)
Product: Placebo C, Semaglutide B 3.0 mg/ml PDS290, Semaglutide B placebo PDS290 pen-injector, Cagrilintide A 10 mg/mL cartridge, NNC0174-0833 A Placebo

Primary endpoint: Improvement in liver fibrosis and no worsening of NASH (Yes/No) from baseline (week 0) to week 52
Endpoint(s): Resolution of steatohepatitis and no worsening of liver fibrosis (Yes/No) from baseline (week 0) to week 52., Improvement in steatohepatitis with at least a 2-point reduction in NAS and no worsening of fibrosis (Yes/No) from baseline (week 0) to week 52., Change in histology-assessed liver collagen proportionate area from baseline (week 0) to week 52., Resolution of steatohepatitis and improvement in liver fibrosis (Yes/No) from baseline (week 0) to week 52., Improvement in liver fibrosis (Yes/No) from baseline (week 0) to week 52., Progression of liver fibrosis (Yes/No) from baseline (week 0) to week 52. For subjects with fibrosis stage 2 or 3 at baseline., Worsening in steatohepatitis (Yes/No) from baseline (week 0) to week 52., Improvement in ballooning (Yes/No) from baseline (week 0) to week 52., Improvement in inflammation (Yes/No) from baseline (week 0) to week 52., Improvement in steatosis (Yes/No) from baseline (week 0) to week 52., Change in ALT from baseline (week 0) to week 52., Change in AST from baseline (week 0) to week 52., Change in inflammation assessed by HsCRP from baseline (week 0) to week 52., Change in ELF score from baseline (week 0) to week 52., Change in HbA1c from baseline (week 0) to week 52. For subjects with type 2 diabetes., Change in triglycerides from baseline (week 0) to week 52., Change in free fatty acids from baseline (week 0) to week 52., Change in LDL cholesterol from baseline (week 0) to week 52., Change in HDL cholesterol from baseline (week 0) to week 52., Relative change in body weight from baseline (week 0) to week 52., Change in SF-36 bodily pain from baseline (week 0) to week 52., Change in NASH-CHECK pain from baseline (week 0) to week 52., Change in PROMIS Fatigue score from baseline (week 0) to week 52., Number of treatment emergent adverse events (TEAEs) from baseline (week 0) to week 59.

Source: https://euclinicaltrials.eu/ctis-public/view/2023-506961-74-00